EU clinical trial 2023-504419-34-00: A three-period multicenter study, with a randomized-withdrawal, double-blinded, placebo-controlled design to evaluate the clinical efficacy, safety and tolerability of MAS825 in patients with monogenic IL-18 driven autoinflammatory diseases, including NLRC4-GOF, XIAP deficiency, or CDC42 mutations.
Protocol code: CMAS825D12201
Sponsor: Novartis Pharma AG (Pharmaceutical company). Phase: Therapeutic exploratory (Phase II). Countries: France (ongoing, recruitment ended), Spain (ended), Czechia (ongoing, recruitment ended), Italy (ongoing, recruitment ended).
Therapeutic area(s): Diseases [C] - Congenital, Hereditary, and Neonatal Diseases and Abnormalities [C16]
Gender: Female, Male. Age: 0-17 years, 18-64 years. Enrolment: 9.
Start date (EU): 2021-04-29. Decision date: 2024-06-10. Results received: No. Last updated: 2026-07-30.
Decision dates by country: ES: 2024-06-10, FR: 2024-06-11, CZ: 2024-06-10, IT: 2024-06-12

Condition(s): Autoinflammatory diseases including NLRC4-Gain of Function (GOF) also known as AIFEC (autoinflammation with infantile enterocolitis), X-linked Inhibitor of Apoptosis Protein (XIAP) deficiency, or Cell division control protein 42 homolog (CDC42) mutation.
Product: Placebo to MAS825 100 mg/1 mL Concentrate for solution for infusion / Solution for injection, CICLOSPORIN, MAS825

Primary endpoint: Occurrence of disease flare in patients with MAS825 treated patients compared with placebo during Period 2 assessed by Physician's Global Assessment and inflammatory markers
Endpoint(s): - Confirmation of serological markers of MAS825, - PGA and inflammatory markers at Day 29, end of Period 1 and Period 2, - Serological remission via inflammatory markers, - Glucocorticoid therapy ≤0.2mg/kg/day by end of period 1, - Time to first flare during period 2, - Physician Severity Assessment of Disease Signs and Symptoms scale, - Patient' / Parent's global assessment of disease activity (PPGA) scale

Source: https://euclinicaltrials.eu/ctis-public/view/2023-504419-34-00